EU clinical trial 2024-515893-29-01: Specifying the anti-inflammatory effects of ziltivekimab with diverse imaging modalities and in-depth cellular phenotyping (SPIDER)
Protocol code: 83403
Sponsor: Stichting Amsterdam UMC (Hospital/Clinic/Other health care facility). Phase: Phase II and Phase III (Integrated). Countries: Netherlands (ongoing, recruitment ended).
Therapeutic area(s): Diseases [C] - Cardiovascular Diseases [C14]
Gender: Female, Male. Age: 18-64 years, 65+ years. Enrolment: 40.
Status: Ongoing, recruitment ended. Start date (EU): 2024-11-19. Decision date: 2024-11-19. Results received: No. Last updated: 2024-11-19.

Condition(s): Coronary artery disease
Product: Ziltivekimab B 15 mg/mL DV3430-C1

Primary endpoint: Mean percentage change in coronary arteries target to background ratio (TBRmax) and monocyte activation marker protein expression between the treatment and placebo group, at the primary analysis time point of 20 weeks, compared to baseline.
Endpoint(s): Difference in PCAT (CCTA derived) after ziltivekimab treatment, Correlation between changes in coronary 68Ga-DOTATATE uptake and anatomical plaque changes on CCTA., Difference in 68Ga-DOTATATE SUVmax of bone marrow and spleen after treatment., Difference in 68Ga-DOTATATE TBRmax of ascending aorta after treatment., The impact of ziltivekimab on monocyte phenotype in transendothelial migration (TEM) capacity and transcriptome profile., The mean percentage change in plasmatic proteins before and after ziltivekimab treatment., The impact of ziltivekimab on inflammation in plasma cytokine and chemokine levels.

Source: https://euclinicaltrials.eu/ctis-public/view/2024-515893-29-01